EU clinical trial 2023-510173-34-00: A long-term follow-up study for patients treated with Galapagos CAR T-cell therapies
Protocol code: LTF-CL-001
Sponsor: Lakefront Biotherapeutics (Pharmaceutical company). Phase: Therapeutic confirmatory (Phase III). Countries: Belgium (ongoing, recruiting), Spain (ongoing, recruiting), Netherlands (ongoing, recruiting), Finland (ongoing, recruiting).
Therapeutic area(s): Diseases [C] - Neoplasms [C04]
Gender: Female, Male. Age: 18-64 years, 65+ years. Enrolment: 309.
Status: Ongoing, recruiting. Start date (EU): 2024-07-26. Decision date: 2024-06-17. Results received: No. Last updated: 2026-06-23.
Decision dates by country: NL: 2024-06-20, ES: 2024-06-21, BE: 2024-06-17, FI: 2026-03-25

Condition(s): Relapsed/refractory B-Cell non-Hodgkin lymphoma, Relapsed or refractory Chronic Lymphocytic Leukemia (CLL) or Small Lymphocytic Lymphoma (SLL), Relapsed/refractory multiple myeloma
Product: 19CP02, BCMACP03, BCN-CP01

Primary endpoint: The type and incidence of targeted adverse events (AEs), The type and incidence of serious AEs (SAEs) considered related to the GLPG CAR T-cell therapy, The pattern of vector integration sites, if vector sequences are detected in new malignancies, or in at least 1% of peripheral blood mononuclear cells (PBMCs), The incidence of detectable replication-competent lentivirus (RCL) in peripheral blood, Cause-specific mortality
Endpoint(s): Disease progression status, Time to subsequent anticancer therapy, Overall survival, The incidence of detectable CAR transgene in peripheral blood over time

Source: https://euclinicaltrials.eu/ctis-public/view/2023-510173-34-00